EU clinical trial 2024-516884-10-00: A MULTICENTER, PROSPECTIVE, RANDOMIZED, DOUBLE-BLIND, PLACEBO-CONTROLLED TRIAL OF SPIRONOLACTONE FOR THE TREATMENT OF ACTIVE RHEUMATOID ARTHRITIS (RA) - ALDORA
Protocol code: 8154
Sponsor: Les Hopitaux Universitaires De Strasbourg (Hospital/Clinic/Other health care facility). Phase: Therapeutic confirmatory (Phase III). Countries: Germany (ended), France (ended).
Therapeutic area(s): Diseases [C] - Musculoskeletal Diseases [C05]
Gender: Female, Male. Age: 18-64 years, 65+ years. Enrolment: 153.
Status: Ended. Start date (EU): 2022-06-22. End date (EU): 2026-02-24. Decision date: 2024-09-09. Results received: No. Last updated: 2024-09-11.
Decision dates by country: FR: 2024-09-09, DE: 2024-09-11

Condition(s): RHEUMATOID ARTHRITIS
Product: Microcrystalline cellulose, lactose monohydrate, magnesium stearate, colloidal anhydrous silica. Coating: similar color to the reference, type Opadry HP II (assumption: Opadry white HP 85F18422), SPIRONOLACTONE VIATRIS 25 mg, comprimé pelliculé sécable

Primary endpoint: Proportion of patients achieving DAS28-CRP < 3,2, comparison between spironolactone and placebo arms
Endpoint(s): Adverse events / Serious adverse events rate in each arm, NT-proBNP level, Cardiac parameters : QRS duration (ms); left ventricular end-diastolic volume index (mL/m2), left ventricular ejection fraction (%); left ventricular mass index (g/m2); left atrial volume index (mL/m2); early mitral flow; velocity (E) (m/s); late (atrial) mitral flow velocity (A) (m/s); E/A ratio; E/ early diastolic tissue velocity (e'); tricuspid annular plane systolic excursion, CDAI score, Proportion of patients achieving DAS28-CRP < 3,2 at 6 months, EULAR/ACR 20, 50, 70 2010 classification score and Boolean remission score at 3 and 6 months, Concomitant treatment modification, Treatment account (treatment boxes and patient diary), RAPID 3 and HAQ scores

Source: https://euclinicaltrials.eu/ctis-public/view/2024-516884-10-00